EU clinical trial 2023-505934-86-00: Effects of an Opioid Sparing Care Pathway for Patients undergoing Obesity Surgery
Sponsor: Vaestra Goetalandsregionen (Hospital/Clinic/Other health care facility). Phase: Therapeutic use (Phase IV). Countries: Sweden (ongoing, recruiting).
Therapeutic area(s): Analytical, Diagnostic and Therapeutic Techniques and Equipment [E] - Anesthesia and Analgesia [E03]
Gender: Female, Male. Age: 18-64 years, 65+ years. Enrolment: 220.
Status: Ongoing, recruiting. Start date (EU): 2019-03-26. Decision date: 2024-01-31. Results received: No. Last updated: 2026-03-16.

Condition(s): Obesity, Pain, postoperative
Product: REMIFENTANIL HYDROCHLORIDE, ESKETAMINE, LIDOCAINE HYDROCHLORIDE MONOHYDRATE, DEXMEDETOMIDINE

Primary endpoint: No difference in patient-reported pain score according to NRS (Numeric Rating Scale, 0-10), calculated as a deviation of one scale step within the NRS scale, between the intervention group patients compared to conventional treatment (control group) postoperatively. NRS (numeric rating scale for pain) during the last 24 hours (scale 0-10, 'no pain' vs. 'worst imaginable pain').
Endpoint(s): An opioid-sparing treatment provides improved combined outcomes (composite score) consisting of 1) Self-Efficacy, 2) Postoperative Quality of Recovery Scale (PQRS), hospital readmission, or death at 3 months compared to conventional treatment., An opioid-sparing treatment results in reduced opioid consumption during the peri- and postoperative period until discharge to the ward compared to conventional treatment., An opioid-sparing treatment results in reduced opioid consumption throughout the hospital stay compared to conventional treatment., An opioid-sparing treatment results in decreased pain experience according to the Numeric Rating Scale (NRS) at 3 months and 6 months compared to conventional treatment., An opioid-sparing treatment leads to earlier recovery after surgery measured with PQRS compared to conventional treatment postoperatively (20 minutes, 40 minutes), during hospitalization (24-72 hours), and thereafter (14 days, 30 days, 3 months, 6 months, 12 months, and 24 months)., An opioid-sparing treatment increases confidence in coping with unexpected events measured with the General Self-Efficacy Scale compared to conventional treatment after the in-hospital period (3 months, 6 months, 12 months, 24 months)., An opioid-sparing treatment improves quality of life measured with RAND-36 and EQ5D compared to conventional treatment after the in-hospital period (3 months, 6 months, 12 months, 24 months)., An opioid-sparing treatment results in equivalent length of hospital stay compared to conventional treatment during the in-hospital period., Mapping of long-term prescription of analgesic drugs. Does an opioid-sparing treatment impact the long-term use of analgesic medications., Cost-minimization analysis/cost effectiveness analysis from a healthcare perspective. Micro-costing assessment of perioperative and surgery ward resource use, including healthcare consumption up to 6 months postoperatively.

Source: https://euclinicaltrials.eu/ctis-public/view/2023-505934-86-00